EU clinical trial 2024-515107-19-00: ANTIBIOBONTA - Assessment of the interest of a peri-operative antibiotic strategy applied to patients with asymptomatic bacteriuria undergoing intra-vesical botulinum toxin A injections
Protocol code: DRI_2020/03
Sponsor: Centre Hospitalier Universitaire De Lille (Hospital/Clinic/Other health care facility). Phase: Therapeutic confirmatory (Phase III). Countries: France (authorised, recruitment pending).
Therapeutic area(s): Diseases [C] - Nervous System Diseases [C10]
Gender: Female, Male. Age: 18-64 years, 65+ years. Enrolment: 526.
Status: Authorised, recruitment pending. Decision date: 2025-11-10. Results received: No. Last updated: 2026-07-03.

Condition(s): Patients (male or female) ≥18 years old with Detrusor overactivity (DO) in multiple sclerosis (MS) or spinal cord injured (SCI).
Product: OROKEN 200 mg, comprimé pelliculé, ROCEPHINE 1 g/3,5 ml, poudre et solvant pour solution injectable (IM), ROCEPHINE 1 g/10 ml, poudre et solvant pour solution injectable (IV), AUGMENTIN 500 mg/62,5 mg, comprimé pelliculé (rapport amoxicilline/acide clavulanique : 8/1), DELPRIM 300 mg comprimé sécable, SELEXID 200 mg, comprimé pelliculé, CIFLOX 500 mg, comprimé pelliculé sécable, MONURIL 3 g, granulés pour solution buvable en sachet, Clamoxyl 1 g, comprimés dispersibles, BACTRIM FORTE, comprimé, AZACTAM 1 g, poudre et solution pour usage parentéral, TAVANIC 500 mg, comprimé pelliculé sécable, OFLOCET 200 mg, comprimé pelliculé sécable, FURADANTINE 50 mg, gélule

Primary endpoint: Rate of patients with symptomatic UTI occurring within the 6 weeks following intra-vesical BoNTA injection. Symptomatic UTI will be defined according to the National Institute on Disability and Rehabilitation Research (NIDRR, 1992) as a significant bacteriuria with tissue invasion and resultant tissue response with signs and/or symptoms of UTI
Endpoint(s): Rate of patients with febrile symptomatic UTI occurring within the 6 weeks following intra-vesical BoNTA injection., Rate of patients with non-febrile symptomatic UTI occurring within the 6 weeks following intra-vesical BoNTA injection., Rate of patients with symptomatic UTI within the 6 weeks following intra-vesical BoNTA injection finally needing the administration of an antibiotic therapy., Rate of patients with adverse events (other than symptomatic UTI) related to* intra-vesical BoNTA injections occurring within the 6 weeks following the injection., Rate of patients with adverse events not related to** intra-vesical BoNTA injection occurring within the 6 weeks following the injection, Rate of patients with admission to an emergency unit related to* intra-vesical BoNTA injection occurring within the 6 weeks following the injection., Rate of patients with admission to an emergency unit not related** to intra-vesical BoNTA injection occurring within the 6 weeks following the injection, Rate of patients with admission in a non-scheduled hospitalization related to* intra-vesical BoNTA injection occurring within the 6 weeks following the injection, Rate of patients with admission in a non-scheduled hospitalization not related to* intra-vesical BoNTA injection occurring within the 6 weeks following the injection., Maximal cystometric capacity (MCC) evaluated 6 weeks after BoNTA injection (UDS)., Rate of patients with DO (unhibited detrusor contraction(s) occurring during feeling phase) evaluated 6 weeks after BoNTA injection (UDS). o If DO: Volume at the first uninhibited detrusor contraction (ml) o If DO: Maximal detrusor pressure (cmH2O), Number of CISC per day evaluated 6 weeks after BoNTA injection (3-day bladder diary)., Number of urgency episodes evaluated 6 weeks after BoNTA injection (3-day bladder diary)., Number of urinary incontinence episodes per day evaluated 6 weeks after BoNTA injection (3-day bladder diary)., Functional bladder capacity evaluated 6 weeks after BoNTA injection (3-day bladder diary).

Source: https://euclinicaltrials.eu/ctis-public/view/2024-515107-19-00